EU clinical trial 2023-505338-93-00: Comparison of multiple doses of intramuscular versus intranasal naloxone for reversal of opioid toxicity
Sponsor: Leiden University Medical Center (Hospital/Clinic/Other health care facility). Phase: Therapeutic exploratory (Phase II). Countries: Netherlands (ended).
Therapeutic area(s): Phenomena and Processes [G] - Physiological processes [G07]; Diseases [C] - Respiratory Tract Diseases [C08]
Gender: Female, Male. Age: 18-64 years. Enrolment: 22.
Status: Ended. Start date (EU): 2023-09-21. End date (EU): 2024-09-06. Decision date: 2023-08-14. Results received: Yes. Last updated: 2023-08-14.

Condition(s): Healthy volunteers
Product: ZIMHI™ (naloxone hydrochloride injection) for intramuscular or subcutaneous use, Naloxone 400 micrograms/ml solution for injection/infusion, NARCAN® (naloxone hydrochloride) nasal spray, Fentanyl hameln 50 microgram/ml, oplossing voor injectie

Primary endpoint: • Number of naloxone administrations
Endpoint(s): • Number of naloxone administrations, • Timing of minute ventilation, end-tidal PCO2 and plasma concentrations of naloxone, • Plasma concentrations of naloxone and fentanyl, • Pupil diameter and muscle tone

Source: https://euclinicaltrials.eu/ctis-public/view/2023-505338-93-00